EU clinical trial 2024-515291-13-00: Adjuvant dendritic-cell immunotherapy plus temozolomide following surgery and chemoradiation in patients with newly diagnosed glioblastoma
Protocol code: ADDIT-GLIO
Sponsor: Antwerp University Hospital (Hospital/Clinic/Other health care facility). Phase: Therapeutic exploratory (Phase II). Countries: Belgium (ongoing, recruitment ended).
Therapeutic area(s): Diseases [C] - Neoplasms [C04]; Analytical, Diagnostic and Therapeutic Techniques and Equipment [E] - Therapeutics [E02]; Phenomena and Processes [G] - Immune system processes [G12]; Diseases [C] - Nervous System Diseases [C10]
Gender: Female, Male. Age: 18-64 years, 65+ years. Enrolment: 20.
Status: Ongoing, recruitment ended. Start date (EU): 2016-04-01. Decision date: 2024-11-06. Results received: No. Last updated: 2026-01-22.
Decision dates by country: BE: 2024-12-10

Condition(s): Glioblastoma grade IV
Product: WT1 LAMP mRNA DC

Primary endpoint: Overall survival (OS) and progression-free survival (PFS)
Endpoint(s): Feasibility will be assessed based on the number of (A) patients in the intention-to-treat (ITT) population that had a successful leukapheresis (B) patients in the ITT population that had production of qualified (phenotypic and functional requirements) vaccines (C) efficacy evaluable patients in the ITT population (D) patients with 3-weekly DC vaccine administration following chemoradiation and additional DC vaccination at day 21 of each maintenance chemotherapy cycle in the ITT population, Safety will be assessed based on adverse event frequency (scored according to the latest version of the National Cancer Institute Common Terminology Criteria for Adverse Events) in the safety population, Immunogenicity will be assessed based on ex vivo immune responses of all patients of the immunogenicity population

Source: https://euclinicaltrials.eu/ctis-public/view/2024-515291-13-00